EU clinical trial 2024-512514-18-00: AMASCIS-02. ALOGENIC ADIPOSE TISSUE-DERIVED MESENCHYMAL STEM CELLS IN ISCHEMIC STROKE. A PHASE IIB MULTICENTER DOUBLE BLIND PLACEBO CONTROLLED CLINICAL TRIAL.
Protocol code: AMASCIS-02
Sponsor: Fundacion Para La Investigacion Biomedica Del Hospital Universitario La Paz (Patient organisation/association). Phase: Therapeutic exploratory (Phase II). Countries: Spain (ongoing, recruitment ended).
Therapeutic area(s): Diseases [C] - Nervous System Diseases [C10]
Gender: Female, Male. Age: 18-64 years, 65+ years. Enrolment: 30.
Status: Ongoing, recruitment ended. Start date (EU): 2020-09-17. Decision date: 2024-04-03. Results received: No. Last updated: 2024-04-03.

Condition(s): ISCHEMIC STROKE
Product: Allogenic adipose-derived mesenchymal stem cells expanded

Primary endpoint: The safety of mesenchymal stem cells from adipose tissue will be assessed using the following parameters: Adverse events (AES) reported spontaneously or in response to questions not addressed. Serious adverse events. Neurological and systemic complications: deteriorating stroke, stroke recurrences, brain oedema, seizures, haemorrhagic transformation, respiratory infections, urinary tract infections, deep venous thrombosis and pulmonary embolism.
Endpoint(s): Modified Rankin Scale (mRS): success is considered positive when the patient obtains a score of 0-3, and failure scores of 4 to 6 at months 3, 6, 12 and 24. Additional exploratory efficacy analysis: mRS shift at months 3, 6, 12 and 24., NIH Stroke Scale: It will be measured at all the scheduled visits. Success is considered positive when the patient obtains an improvement of 75% or more from baseline. Additional exploratory efficacy analysis: differences in the distribution of median (IQR) and in the frequency of NIHSS ≤1 between groups., Biochemical markers. They will be measured at baseline, day 7 and month 3.

Source: https://euclinicaltrials.eu/ctis-public/view/2024-512514-18-00